EU clinical trial 2023-508445-40-00: A double blind, placebo controlled, parallel, study to evaluate the effects of NAL in Obstructive Sleep Apnea Patients.
Protocol code: NAL-II-23-1
Sponsor: Laboratoires S.M.B. (Pharmaceutical company). Phase: Therapeutic exploratory (Phase II). Countries: France (ended), Belgium (ended).
Therapeutic area(s): Diseases [C] - Respiratory Tract Diseases [C08]
Gender: Female, Male. Age: 18-64 years, 65+ years. Enrolment: 72.
Status: Ended. Start date (EU): 2024-07-01. End date (EU): 2026-03-05. Decision date: 2024-05-21. Results received: No. Last updated: 2025-08-26.
Decision dates by country: FR: 2024-05-21, BE: 2024-05-22

Condition(s): Obstructive Sleep Apnea
Product: Placebo of NAL, NACYSTELYN

Primary endpoint: The primary endpoint will be the mean change in Apnea-Hypopnea Index (PSG-AHI3%) from baseline to 6 weeks of treatment.
Endpoint(s): Absolute change in the mandibular movement respiratory disturbance index (MM-RDI) from baseline to week 6, Absolute change in the mandibular movement respiratory effort (MM-RE) from baseline to week 6, Absolute change in apnea-hypopnea index (AHI) measured by Sunrise® from baseline to week 6, Absolute change in the number of apnea episodes from baseline to week 6, Absolute change in the number of hypopnoea episodes from baseline to week 6, Absolute change in the longest apnoeic episode duration from baseline to week 6, Absolute change in the oxygen desaturation index (ODI) from baseline to week 6, Absolute change in the time under 90% oxygen saturation (T90%) from baseline to week 6, Absolute change in the mean arterial oxygen saturation (MSaO2) from baseline to week 6, Absolute change in the lowest arterial oxygen saturation (LSaO2) from baseline to week 6, Absolute change in the pulse wave amplitude drops (PWADs) index from baseline to week 6, Absolute change in the relative snore time from baseline to week 6, Absolute change in the number of snore episodes from baseline to week 6, Absolute change in the longest snoring episode from baseline to week 6, Absolute change in the Epworth sleepiness score (ESS) from baseline to week 6, Absolute change in the participant-reported score of nasal obstruction symptom evaluation (NOSE) questionnaire from baseline to week 6, Absolute change in the participant-reported score from Pichot’s fatigue scale from baseline to week 6, Absolute change in the participant-reported score from Patient Health Questionnaire (PHQ-9) from baseline to week 6, Absolute change in oxidative stress and inflammation biomarkers from baseline to week 6., Adverse events, vital signs, physical examination and Concomitant medication use, Absolute change in PSG-AHI4% from baseline to 6 weeks of treatment, Absolute change in the Total sleep time (TST) from baseline to week 6

Source: https://euclinicaltrials.eu/ctis-public/view/2023-508445-40-00